EU clinical trial 2024-512737-33-00: A Phase 3 Global, Randomized, Double-Blind, Placebo-Controlled, 48-Week, Parallel-Group Study of the Efficacy and Safety of Losmapimod in Treating Patients With Facioscapulohumeral Muscular Dystrophy (FSHD) (REACH)
Protocol code: 1821-FSH-301
Sponsor: Fulcrum Therapeutics Inc. (Pharmaceutical company). Phase: Therapeutic confirmatory (Phase III). Countries: Italy (ended), Spain (ended), France (ended), Germany (ended), Netherlands (ended), Denmark (ended).
Therapeutic area(s): Diseases [C] - Nervous System Diseases [C10]; Diseases [C] - Musculoskeletal Diseases [C05]
Gender: Female, Male. Age: 18-64 years, 65+ years. Enrolment: 144.
Status: Ended. Start date (EU): 2022-09-30. End date (EU): 2024-10-28. End date: 2024-11-20. Decision date: 2024-08-06. Results received: Yes. Last updated: 2024-08-13.
Decision dates by country: FR: 2024-08-08, DK: 2024-08-13, IT: 2024-08-12, ES: 2024-08-06, DE: 2024-08-08, NL: 2024-08-06

Condition(s): Facioscapulohumeral Muscular Dystrophy (FSHD)
Product: PL1 - Placebo to match losmapimod tablets are tablets for oral administration and visually match the active losmapimod tablets, 15 mg., Losmapimod

Primary endpoint: Part A: Change from baseline in average total RSA Q1-Q5 with 500 g wrist weight at Week 48, where average is applied over both arms Part B: Safety and tolerability of long-term treatment with losmapimod, based on the assessment of AEs, clinical laboratory tests, ECGs, vital signs, and physical examinations
Endpoint(s): Part A: 1. PGIC at Week 48 2. Change from baseline in WB longitudinal composite MFI of B muscles at Week 48 3. Relative change from baseline in average shoulder abductor strength by hand-held quantitative dynamometry at Week 48 4. Change from baseline in Neuro-QoL UE at Week 48, 5. Safety and tolerability, based on the assessment of AEs, clinical laboratory tests, ECGs, vital signs and physical examinations. Part B: No secondary endpoints

Source: https://euclinicaltrials.eu/ctis-public/view/2024-512737-33-00